EU clinical trial 2025-521038-27-00: A Multicenter, Multinational, Randomized, Double-blind, Placebo-Controlled, Phase 3 Maintenance Study to Evaluate the Efficacy and Safety of Duvakitug in Participants with Moderately to Severely Active Ulcerative Colitis
Protocol code: EFC18359
Sponsor: Sanofi-Aventis Recherche & Developpement (Pharmaceutical company). Phase: Therapeutic confirmatory (Phase III). Countries: Slovakia (authorised, recruitment pending), Germany (ongoing, recruiting), Austria (ongoing, recruiting), Italy (authorised, recruitment pending), Czechia (authorised, recruitment pending), Netherlands (authorised, recruitment pending), Poland (ongoing, recruiting), Belgium (authorised, recruitment pending), Hungary (authorised, recruitment pending), Lithuania (ongoing, recruiting), Greece (authorised, recruitment pending), France (authorised, recruitment pending), Bulgaria (authorised, recruitment pending), Spain (authorised, recruitment pending), Norway (authorised, recruitment pending).
Therapeutic area(s): Diseases [C] - Immune System Diseases [C20]
Gender: Female, Male. Age: 0-17 years, 18-64 years, 65+ years. Enrolment: 209.
Start date (EU): 2026-06-23. Decision date: 2026-02-09. Results received: No. Last updated: 2026-07-17.
Decision dates by country: AT: 2026-02-09, BE: 2026-02-12, FR: 2026-02-09, LT: 2026-02-11, NL: 2026-02-11, GR: 2026-02-11, SK: 2026-02-10, NO: 2026-03-02, BG: 2026-02-13, HU: 2026-02-16, DE: 2026-02-10, CZ: 2026-02-10, PL: 2026-02-16, IT: 2026-02-11, ES: 2026-02-16

Condition(s): Immune system diseases
Product: matched placebo for test product, Duvakitug

Primary endpoint: Pivotal Maintenance Sub-Study Cohort 1: Proportion of participants achieving clinical remission by modified Mayo Score (mMS).
Endpoint(s): Pivotal Maintenance Sub-Study Cohort 1: Proportion of participants with endoscopic improvement., Pivotal Maintenance Sub-Study Cohort 1: Proportion of participants achieving histologic endoscopic mucosal improvement., Pivotal Maintenance Sub-Study Cohort 1: Proportion of participants with corticosteroid-free clinical remission., Proportion of participants with no bowel urgency., Pivotal Maintenance Sub-Study Cohort 1: Change from Baseline in PROMIS- Fatigue Short Form 7a T-score., Pivotal Maintenance Sub-Study Cohort 1: Proportion of participants with endoscopic remission., Pivotal Maintenance Sub-Study Cohort 1: Proportion of participants achieving clinical remission by mMS, in the subset of participants who achieved clinical remission by mMs at the end of induction period (maintenance of clinical remission)., Pivotal Maintenance Sub-Study Cohort 1: Proportion of participants with no abdominal pain by Numerical Rating Scale (NRS)., Pivotal Maintenance Sub-Study Cohort 1: Change from baseline in Inflammatory Bowel Disease Questionnaire (IBDQ) total score., Pivotal Maintenance Sub-Study Cohort 1: Incidence of UC-related hospitalizations., Pivotal Maintenance Sub-Study Cohort 1: Proportion of participants with symptomatic (stool-frequency sub score [SFS] and = rectal bleeding sub score [RBS]) remission., Pivotal Maintenance Sub-Study Cohort 1: Proportion of participants achieving clinical remission and no steroid use from the baseline to the time of endpoint analysis., Pivotal Maintenance Sub-Study Cohort 1: Incidence of Treatment-Emergent Adverse Events (TEAEs), Treatment-Emergent Adverse Events of Special Interest (TEAESIs), Treatment-Emergent Serious Adverse Events (TESAEs), and Treatment-Emergent Adverse Events (TEAEs) leading to permanent study intervention discontinuation., Pivotal Maintenance Sub-Study Cohort 1: Serum concentration of duvakitug measured over time., Pivotal Maintenance Sub-Study Cohort 1: Incidence of treatment-emergent Anti-Drug Antibodies (ADA) against duvakitug., Open-Label Extension Sub-Study: Incidence of Treatment-Emergent Adverse Events (TEAEs), Treatment-Emergent Adverse Events of Special Interest (TEAESIs), Treatment-Emergent Serious Adverse Events (TESAEs), and Treatment-Emergent Adverse Events (TEAEs) leading to permanent study intervention discontinuation.

Source: https://euclinicaltrials.eu/ctis-public/view/2025-521038-27-00